EU clinical trial 2025-523576-23-00: ROSETTA Lung-201: A Randomized, Multicenter, Open-label Phase 3 study of Pumitamig Monotherapy Compared to Durvalumab in Participants with Unresectable Stage III NSCLC Without Progression After Platinum-based Concurrent Chemoradiation Therapy
Protocol code: CA2660001
Sponsor: Bristol-Myers Squibb Services Unlimited Company (Pharmaceutical company). Phase: Therapeutic confirmatory (Phase III). Countries: France (authorised, recruiting), Ireland (authorised, recruiting), Germany (ongoing, recruiting), Greece (ongoing, recruiting), Bulgaria (authorised, recruiting), Spain (ongoing, recruiting), Netherlands (authorised, recruiting), Italy (authorised, recruiting), Sweden (ongoing, recruiting), Romania (ongoing, recruiting), Hungary (authorised, recruitment pending), Belgium (authorised, recruitment pending), Austria (authorised, recruiting), Poland (authorised, recruiting).
Therapeutic area(s): Diseases [C] - Neoplasms [C04]
Gender: Female, Male. Age: 18-64 years, 65+ years. Enrolment: 279.
Start date (EU): 2026-06-12. Decision date: 2026-05-22. Results received: No. Last updated: 2026-06-25.
Decision dates by country: AT: 2026-05-25, BG: 2026-05-26, FR: 2026-05-22, DE: 2026-05-26, GR: 2026-05-25, HU: 2026-05-26, IE: 2026-05-22, IT: 2026-05-26, RO: 2026-05-27, ES: 2026-05-26, SE: 2026-05-26, NL: 2026-05-26, PL: 2026-05-26, BE: 2026-05-22

Condition(s): Unresectable Stage III non-small cell lung cancer without progression
Product: DURVALUMAB, BNT327 50 mg ml, BNT327 20 mg ml

Primary endpoint: to find out which medicine works better at delaying cancer growth (progression-free survival; PFS by BICR)
Endpoint(s): To see if participants live longer when taking pumitamig instead of durvalumab (Overall Survival; OS), Measuring how long it takes for the cancer to get worse, as judged by the participant’s doctor (PFS by investigator), Seeing how many participant’s tumors shrink or disappear with each medicine (Objective Response; OR), Seeing how many participants have their cancer stay the same size or shrink (Disease Control Rate; DCR), Measuring how long tumors stay smaller or stable after improving (Duration of Response; DOR), Timing how quickly tumors start to shrink after treatment (Time to Response; TTR), Look at how safe each medicine is and how well participants tolerate them

Source: https://euclinicaltrials.eu/ctis-public/view/2025-523576-23-00